EU clinical trial 2022-500797-34-00: A Phase 2 Study of Olaparib Monotherapy in Participants with Previously Treated, Homologous Recombination Repair Mutation (HRRm) or Homologous Recombination Deficiency (HRD) Positive Advanced Cancer
Protocol code: MK-7339-002
Sponsor: Merck Sharp & Dohme LLC (Pharmaceutical company). Phase: Therapeutic exploratory (Phase II). Countries: Ireland (ended), Denmark (ended), Spain (ended), Italy (ended), Romania (ended), France (ended).
Therapeutic area(s): Diseases [C] - Neoplasms [C04]
Gender: Female, Male. Age: 18-64 years, 65+ years. Enrolment: 27.
Status: Ended. Start date (EU): 2018-12-17. End date (EU): 2025-12-11. Decision date: 2023-02-22. Results received: No. Last updated: 2025-11-17.
Decision dates by country: RO: 2023-03-24, DK: 2023-02-22, ES: 2023-03-15, FR: 2023-02-24, IE: 2023-03-10, IT: 2023-03-20

Condition(s): Treatment of participants with positive cancer for HRRm or HRD.
Product: Olaparib, Olaparib

Primary endpoint: Objective Response Rate (ORR)
Endpoint(s): Duration of Response (DOR), Overall Survival (OS), Progression Free Survival (PFS), Number of Participants Experiencing an Adverse Event (AE), Number of Participants Discontinuing Study Treatment due to an Adverse Event (AE), Objective Response Rate (ORR) in Participants with HRRm or HRD Positive Cancer, Time to Earliest Progression by Cancer Antigen-125 (CA-125), Prostate-specific Antigen (PSA) Response Rate in Participants with Prostate Cancer, Progression-Free Survival After Next-Line Treatment in Participants with sBRCAm Breast Cancer

Source: https://euclinicaltrials.eu/ctis-public/view/2022-500797-34-00